EU clinical trial 2023-506669-70-00: A Phase 3, Randomized, Double-blind, Placebo-controlled, Multicenter Study to Evaluate the Efficacy and Safety of Amyloid Depleter ALXN2220 in Adult Participants with Transthyretin Amyloid Cardiomyopathy (ATTR-CM)
Protocol code: ALXN2220-ATTRCM-301
Sponsor: Alexion Pharmaceuticals Inc. (Pharmaceutical company). Phase: Therapeutic confirmatory (Phase III). Countries: Spain (ongoing, recruitment ended), Netherlands (ongoing, recruitment ended), Poland (ongoing, recruitment ended), Italy (ongoing, recruitment ended), Belgium (ongoing, recruitment ended), France (ongoing, recruitment ended), Ireland (ongoing, recruitment ended), Germany (ongoing, recruitment ended), Greece (ongoing, recruitment ended), Austria (ongoing, recruitment ended), Czechia (ongoing, recruitment ended), Denmark (ongoing, recruitment ended), Sweden (ongoing, recruitment ended), Norway (ongoing, recruitment ended).
Therapeutic area(s): Diseases [C] - Cardiovascular Diseases [C14]
Gender: Female, Male. Age: 18-64 years, 65+ years. Enrolment: 346.
Status: Ongoing, recruitment ended. Start date (EU): 2024-04-30. Decision date: 2024-04-12. Results received: No. Last updated: 2026-05-21.
Decision dates by country: AT: 2024-04-17, ES: 2024-04-15, BE: 2024-04-16, DE: 2024-04-16, IT: 2024-04-17, DK: 2024-07-12, CZ: 2024-07-25, SE: 2024-06-24, PL: 2024-04-16, GR: 2024-04-19, NO: 2024-08-19, FR: 2024-04-12, NL: 2024-04-16, IE: 2024-04-19

Condition(s): Adults with Transthyretin Amyloid Cardiomyopathy (ATTR-CM).
Product: ALXN2220 Placebo Product, Recombinant human anti-ATTR immunoglobulin G1 (IgG1) monoclonal antibody (mAb)

Primary endpoint: Total occurrence of ACM and CV clinical events during the Blinded Treatment Period
Endpoint(s): Change from baseline in KCCQ-OS to 24 months, Time to CV related mortality, Change from baseline in 6MWT to 24 months, Rate of CV clinical events, Time to ACM, Incidence of TEAEs and treatment-emergent SAEs. Changes from baseline in physical examination, vital signs, clinical laboratory tests, and 12-lead ECGs, ADA incidence and NAb incidence, response categories and titer, Serum ALXN2220 concentration

Source: https://euclinicaltrials.eu/ctis-public/view/2023-506669-70-00